EU clinical trial 2023-504686-23-00: A PHASE-2B, DOUBLE-BLIND, RANDOMIZED CONTROLLED TRIAL TO EVALUATE THE ACTIVITY AND SAFETY OF INEBILIZUMAB IN ANTI-NMDA RECEPTOR ENCEPHALITIS AND ASSESS MARKERS OF DISEASE (EXTINGUISH)
Protocol code: ExTINGUISH
Sponsor: Erasmus Universitair Medisch Centrum Rotterdam (Erasmus MC) (Hospital/Clinic/Other health care facility). Phase: Therapeutic exploratory (Phase II). Countries: Netherlands (ongoing, recruiting), Spain (ongoing, recruiting).
Therapeutic area(s): Diseases [C] - Immune System Diseases [C20]; Diseases [C] - Nervous System Diseases [C10]
Gender: Female, Male. Age: 18-64 years, 65+ years. Enrolment: 26.
Status: Ongoing, recruiting. Start date (EU): 2024-12-10. Decision date: 2023-10-10. Results received: No. Last updated: 2025-11-13.
Decision dates by country: ES: 2023-10-11, NL: 2023-10-10

Condition(s): anti-N-methyl-D-aspartate receptor encephalitis (anti-NMDAR encephalitis)
Product: Plangamma 50 mg/ml solución para perfusión, METHYLPREDNISOLONE, CETIRIZINE, Flebogamma DIF 50 mg/ml solution for infusion, CYCLOPHOSPHAMIDE, METHYLPREDNISOLONE, Privigen 100 mg/ml solution for infusion, Placebo is saline bag without added substances, labelled and provided by the unblinded hospital site pharmacist, Uplizna 100 mg concentrate for solution for infusion, KIOVIG 100 mg/ml solution for infusion, PARACETAMOL

Primary endpoint: Change in mRS at 16 weeks, Inebilizumab safety, as measured by the number of treatment-emergent adverse events and treatment-emergent serious adverse events from randomization to 24 weeks
Endpoint(s): Time to mRS ≤ 2, corrected for baseline value, over 16 weeks, CASE Score (linear mixed model), corrected from baseline value to Week 24 (Weeks 6 and 16), mRS at Week 6 as measured by proportional odds logistic regression/shift analysis, Proportion of participants who meet the protocol-defined criteria for needing rescue therapy with cyclophosphamide at Week 6, as measured by logistic regression, Cognitive outcome at Week 24 as measured by the total scaled score on the RBANS + total raw score on the TMT, Clinician global impression of change (CGI-I) and Caregiver global impression of change (CaGI) over 24 weeks, as measured by ordinal repeated measures models, Survival as measured by a Kaplan-Meier analysis

Source: https://euclinicaltrials.eu/ctis-public/view/2023-504686-23-00